EU clinical trial 2024-512349-17-00: A prospective, randomized, evaluator- and subject blinded, multi-center investigation to assess efficacy and safety of three different dosages of the same injection pattern of LetibotulinumtoxinA in the treatment of moderate and severe horizontal forehead lines
Protocol code: CPH-LET01
Sponsor: Croma-Pharma GmbH (Pharmaceutical company). Phase: Therapeutic exploratory (Phase II). Countries: Germany (ended), Austria (ended).
Therapeutic area(s): Diseases [C] - Skin and Connective Tissue Diseases [C17]
Gender: Female. Age: 18-64 years, 65+ years. Enrolment: 90.
Status: Ended. Start date (EU): 2024-11-06. End date (EU): 2025-07-28. Decision date: 2024-10-15. Results received: Yes. Last updated: 2025-09-22.
Decision dates by country: DE: 2024-10-15, AT: 2024-10-20

Condition(s): Moderate and severe horizontal forehead lines.
Product: Letybo® 50 Einheiten Pulver zur Herstellung einer Injektionslösung, Letybo 50 Einheiten Pulver zur Herstellung einer Injektionslösung

Primary endpoint: Response - defined as an improvement of ≥ 1 point in CDFLAS score compared to baseline, measured at maximum eyebrow elevation, based on Blinded Evaluating Investigator’s in-clinic assessment - at 4 weeks post treatment (Visit 2).
Endpoint(s): CDFLAS scores at maximum eyebrow elevation, based on Blinded Evaluating Investigator’s in-clinic assessment at Baseline (Screening - Visit 0) and 4, 12, 16, 20 and 24 weeks post treatment (Visit 2 to Visit 6)., Response – defined as an improvement of ≥ 1 point in CDFLAS score compared to baseline, measured at maximum eyebrow elevation, based on Blinded Evaluating Investigator’s in-clinic assessment at 12, 16, 20 and 24 weeks post treatment (Visit 3 to Visit 6)., Pronounced Response – defined as an improvement of ≥ 2 points in CDFLAS score compared to baseline, measured at maximum eyebrow elevation, based on Blinded Evaluating Investigator’s in-clinic assessment at 4, 12, 16, 20 and 24 weeks post treatment (Visit 2 to Visit 6)., Score Response – defined as CDFLAS score 1 or 2, measured at maximum eyebrow elevation, based on Blinded Evaluating Investigator’s in-clinic assessment at 4, 12, 16, 20 and 24 weeks post treatment (Visit 2 to Visit 6)., Skin displacement (ability to elevate the eyebrow in mm) at maximum eyebrow elevation, compared to Baseline (Visit 0 or Visit 1), based on blinded 3D surface imaging measurements at 4, 12, 16, 20 and 24 weeks post treatment (Visit 2 to Visit 6)., The extent of subject’s satisfaction with the overall outcome of the treatment as selfassessed by the blinded subject using the Face-Q (TM) Questionnaire “Satisfaction with Outcome” at 4, 12, 16, 20 and 24 weeks post treatment (Visit 2 to Visit 6)., The extent of subject’s appearance appraisal of the forehead and eyebrows compared to Baseline (Screening – Visit 0) as self-assessed by the blinded subject using the Face-Q (TM) Questionnaire “Appearance Forehead and Eyebrows” at 4, 12, 16, 20 and 24 weeks post treatment (Visit 2 to Visit 6), The extent of subject’s appearance appraisal of forehead lines compared to Baseline (Screening – Visit 0) as self-assessed by the blinded subject using the Face-Q (TM) Questionnaire “Appearance: Lines Forehead” at 4, 12, 16, 20 and 24 weeks post treatment (Visit 2 to Visit 6).

Source: https://euclinicaltrials.eu/ctis-public/view/2024-512349-17-00